EU clinical trial 2024-510667-33-00: A Phase 3, open-label, single-arm, multi-center trial to assess the long-term safety of octreotide subcutaneous depot (CAM2029) in patients with acromegaly
Protocol code: HS-19-647
Sponsor: Camurus AB (Pharmaceutical company). Phase: Therapeutic confirmatory (Phase III). Countries: Hungary (ended), Germany (ended), Spain (ended), Italy (ended), Poland (ended).
Therapeutic area(s): Diseases [C] - Hormonal diseases [C19]
Gender: Female, Male. Age: 18-64 years, 65+ years. Enrolment: 35.
Status: Ended. Start date (EU): 2021-06-03. End date (EU): 2025-04-24. End date: 2025-04-25. Decision date: 2024-04-17. Results received: Yes. Last updated: 2025-02-04.
Decision dates by country: DE: 2024-04-19, HU: 2024-04-17, IT: 2024-04-22, ES: 2024-04-17, PL: 2024-04-22

Condition(s): Acromegaly
Product: CAM2029 (octreotide subcutaneous depot), CAM2029 (octreotide subcutaneous depot)

Primary endpoint: Main part and Extension part of the trial: Characterization of adverse events (AEs)
Endpoint(s): Main part of the trail: Proportion of patients with mean IGF-1 levels ≤1 x upper limit of normal (ULN) and <1.3xULN at Week 50 and Week 52 (average of the 2 measurements), Main part of the trail: Proportion of patients with mean GH levels <2.5 μg/L and <5.0 μg/L at Week 52, Main part of the trail: Proportion of patients/partners declared competent by healthcare professional to administer CAM2029, Main part of the trail: Octreotide plasma concentrations over time, Main part of the trail: Treatment Satisfaction Questionnaire for Medication (TSQM) scores over time using all 4 domains of TSQM (effectiveness, side effects, convenience, and satisfaction), Main part of the trail: Patient satisfaction scale scores at Week 24 and Week 52, Main part of the trail: Change from baseline in Acromegaly Quality of Life Questionnaire (AcroQoL) and EuroQoL 5-dimension 5-level (EQ-5D-5L) scores, Extension part of the trial: IGF-1 levels over time, Extension part of the trial: GH levels over time, Extension part of the trial: TSQM scores over time using all 4 domains of TSQM (effectiveness, side effects, convenience, and satisfaction), Extension part of the trial: AcroQoL, EQ-5D-5L and Short Form-36 (SF-36) scores over time, Extension part of the trial: Work Productivity and Activity Impairment (WPAI) scores over time, Extension part of the trial: Laboratory values, vital signs, ECG readings and gallbladder imaging over time

Source: https://euclinicaltrials.eu/ctis-public/view/2024-510667-33-00